EU clinical trial 2024-511841-20-00: A Phase 2b, Randomized, Double-blind Study Comparing Tremelimumab to Placebo in Second- or Third-line Treatment of Subjects with Unresectable Pleural or Peritoneal Malignant Mesothelioma
Protocol code: D4880C00003
Sponsor: AstraZeneca AB (Pharmaceutical company). Phase: Therapeutic exploratory (Phase II). Countries: Italy (ongoing, recruiting).
Therapeutic area(s): Diseases [C] - Neoplasms [C04]
Gender: Female, Male. Age: 18-64 years, 65+ years. Enrolment: 1.
Status: Ongoing, recruiting. Start date (EU): 2013-09-23. Decision date: 2024-07-29. Results received: No. Last updated: 2026-01-30.

Condition(s): unresectable pleural or peritoneal malignant mesothelioma
Product: Tremelimumab placebo, concentrate for solution for infusion, Tremelimumab

Primary endpoint: The primary endpoint is OS which is defined as the time from randomization until death due to any cause.
Endpoint(s): The secondary efficacy endpoints include OS rate at 18 months, PRO as well as durable DCR, PFS, ORR, and duration of response, based on modified Response Evaluation Criteria in Solid Tumors (RECIST) for pleural mesothelioma and RECIST criteria v1.1 for peritoneal mesothelioma., The safety endpoints include adverse events (AEs) and serious adverse events (SAEs), changes from baseline in clinical laboratory evaluations, electrocardiograms (ECGs), and vital signs. Adverse events and SAEs will be assessed for severity and relationship to investigational product., The immunogenic potential of tremelimumab will be analyzed and the pharmacokinetics of tremelimumab will be assessed.

Source: https://euclinicaltrials.eu/ctis-public/view/2024-511841-20-00